EU clinical trial 2023-509408-13-00: C4221026: ENCORAFENIB/BINIMETINIB MASTER PROTOCOL: AN OPEN-LABEL CONTINUATION STUDY FOR PARTICIPANTS CONTINUING FROM ENCORAFENIB/BINIMETINIB CLINICAL STUDIES
Protocol code: C4221026
Sponsor: Pfizer Inc. (Pharmaceutical company). Phase: Therapeutic use (Phase IV). Countries: Portugal (ongoing, recruiting), Czechia (ongoing, recruiting), Hungary (ongoing, recruiting), France (ended), Netherlands (ongoing, recruiting), Germany (ongoing, recruiting), Italy (ongoing, recruiting), Spain (ongoing, recruiting), Slovakia (authorised, recruitment pending), Greece (authorised, recruitment pending).
Therapeutic area(s): Diseases [C] - Neoplasms [C04]
Gender: Female, Male. Age: 18-64 years, 65+ years. Enrolment: 73.
Start date (EU): 2022-09-20. Decision date: 2024-08-27. Results received: No. Last updated: 2026-06-25.
Decision dates by country: FR: 2024-09-26, NL: 2024-08-27, ES: 2024-08-28, HU: 2024-08-27, PT: 2024-08-27, IT: 2024-09-02, DE: 2024-08-28, CZ: 2024-08-30, SK: 2026-06-08, GR: 2026-04-24

Condition(s): Solid tumors
Product: PEMBROLIZUMAB, NIVOLUMAB, Ribociclib, Braftovi 50 mg hard capsules, Braftovi 75 mg hard capsules, Braftovi 50 mg hard capsules, Ribociclib, Braftovi 75 mg hard capsules, Erbitux 5 mg/mL solution for infusion, Encorafenib, Mektovi 15 mg film-coated tablets, Ribociclib, Zelboraf 240 mg film-coated tablets, Mektovi 15 mg film-coated tablets

Primary endpoint: AEs leading to permanent discontinuation of study interventiona, All SAEs

Source: https://euclinicaltrials.eu/ctis-public/view/2023-509408-13-00